EU clinical trial 2024-514640-81-00: Non-Invasive Ventilation versus High Flow Oxygenotherapy in Patients at High Risk of Extubation Failure
Protocol code: REIOT/0624
Sponsor: Fundacion Para El Fomento De La Investigacion Sanitaria Y Biomedica De La Comunitat Valenciana (Patient organisation/association). Phase: Therapeutic use (Phase IV). Countries: Spain (ongoing, recruiting).
Therapeutic area(s): Diseases [C] - Respiratory Tract Diseases [C08]
Gender: Female, Male. Age: 18-64 years, 65+ years. Enrolment: 260.
Status: Ongoing, recruiting. Start date (EU): 2025-04-23. Decision date: 2024-10-07. Results received: No. Last updated: 2025-01-14.
Decision dates by country: ES: 2025-01-14

Condition(s): Weaning of Mechanical ventilation
Product: Oxígeno Medicinal Líquido Air Liquide 99,5% v/v, gas criogénico medicinal en recipientes fijos.

Primary endpoint: Acute respiratory failure within 48 hours after extubation
Endpoint(s): Intubation, Nosocomial infection, Tracheotomy, Organ failure, ICU Mortality, Hospital mortality, 28-day mortality, ICU length of stay, Hospital length of stay, Duration of mechanical ventilation

Source: https://euclinicaltrials.eu/ctis-public/view/2024-514640-81-00